EU clinical trial 2024-510640-32-00: A Phase I/III, Multi-center, Randomized, Double-blind Study of BAT3306 plus Chemotherapy versus Keytruda® plus Chemotherapy to Evaluate Pharmacokinetics, Efficacy, and Safety in Participants with Stage IV Non-squamous Non-small Cell Lung Cancer.
Protocol code: BAT-3306-002-CR
Sponsor: Bio-Thera Solutions Ltd. (Pharmaceutical company). Phase: Therapeutic confirmatory (Phase III). Countries: Slovakia (ended).
Therapeutic area(s): Diseases [C] - Neoplasms [C04]
Gender: Female, Male. Age: 18-64 years, 65+ years. Enrolment: 23.
Status: Ended. Start date (EU): 2024-10-16. End date (EU): 2025-05-08. End date: 2025-06-09. Decision date: 2024-07-16. Results received: Yes. Last updated: 2025-03-13.

Condition(s): Stage IV Non-squamous non-small cell lung cancer
Product: KEYTRUDA 25 mg/mL concentrate for solution for infusion, Pemetrexed Fresenius Kabi 25 mg/ml concentrate for solution for infusion, Recombinant Humanized Anti-PD-1 Monoclonal Antibody Solution for injection, PEMBROLIZUMAB, Carboplatin Kabi 10 mg/ml Konzentrat zur Herstellung einer Infusionslösung

Primary endpoint: PK parameters, Confirmed best overall tumor response as assessed by BIRC according to RECIST Version 1.1 (tumor assessments after initiation of a new anti-cancer treatment are excluded)
Endpoint(s): PK parameters Ctrough, Vital signs, physical examination, electrocardiogram parameters, clinical laboratory tests, adverse events, Immunogenicity evaluation: ADA positive rate, ADA titer, and NAb, ORR based on tumor response as assessed by BIRC, and confirmed best overall response by the end of study assessed according to RECIST Version 1.1 • DoR • PFS • OS by local radiologist/Investigator after, Relationship between ADA or NAb results and drug concentrations, tumor responses and adverse events

Source: https://euclinicaltrials.eu/ctis-public/view/2024-510640-32-00